EU clinical trial 2026-525260-18-00: Open-label, single-center, single-arm phase 2 futility trial evaluating the oral indapamide for reducing progression of disability in people with primary and secondary progressive multiple sclerosis (MS)
Sponsor: Amsterdam UMC Stichting (Patient organisation/association). Phase: Therapeutic exploratory (Phase II). Countries: Netherlands (authorised, recruitment pending).
Therapeutic area(s): Diseases [C] - Nervous System Diseases [C10]
Gender: Female, Male. Age: 18-64 years. Enrolment: 84.
Status: Authorised, recruitment pending. Decision date: 2026-07-08. Results received: No. Last updated: 2026-07-08.

Condition(s): Multiple Sclerosis
Product: Indapamide Tablets 2.5mg

Primary endpoint: Number of participants with PPMS and SPMS who experience significant (>= 20%) worsening in their T25FW performance at 12 months compared to a baseline measurement.

Source: https://euclinicaltrials.eu/ctis-public/view/2026-525260-18-00